EU clinical trial 2024-516126-54-00: (NEOAC) NEO- and Adjuvant Targeted therapy in braf-mutated Anaplastic Cancer of the Thyroid - a prospective, non-randomized, single center, open-label phase II study.
Sponsor: Leids Universitair Medisch Centrum (LUMC) (Hospital/Clinic/Other health care facility). Phase: Therapeutic exploratory (Phase II). Countries: Netherlands (ongoing, recruiting).
Therapeutic area(s): Diseases [C] - Neoplasms [C04]
Gender: Female, Male. Age: 18-64 years, 65+ years. Enrolment: 20.
Status: Ongoing, recruiting. Start date (EU): 2025-01-21. Decision date: 2024-10-07. Results received: No. Last updated: 2025-02-17.

Condition(s): ANAPLASTIC THYROID CANCER
Product: DABRAFENIB, TRAMETINIB

Primary endpoint: This study aims to increase the number of patients that undergo a successful R0 tumor resection after neo-adjuvant BRAF/MEK inhibitor treatment.
Endpoint(s): To evaluatue: - Neo-adjuvant and adjuvant treatment related toxicity of dabrafenib/trametinib (according to CTCAE v. 5.0) - 30-day postoperative surgical complications - Histopathological response on neo-adjuvant treatment - Locoregional-free survival - Distant metastasis-free survival - Overall survival

Source: https://euclinicaltrials.eu/ctis-public/view/2024-516126-54-00